EU clinical trial 2023-509151-13-00: Fecal Microbiome Transplantation in Cirrhosis. Randomized, Double-blinded, Placebo-Controlled trial in patients with decompensated cirrhosis.
Protocol code: LiverGut
Sponsor: Consorcio Centro De Investigacion Biomedica En Red (Laboratory/Research/Testing facility). Phase: Therapeutic confirmatory (Phase III). Countries: Spain (ongoing, recruiting).
Therapeutic area(s): Diseases [C] - Digestive System Diseases [C06]
Gender: Female, Male. Age: 18-64 years, 65+ years. Enrolment: 190.
Status: Ongoing, recruiting. Start date (EU): 2025-07-04. Decision date: 2025-01-15. Results received: No. Last updated: 2025-04-30.

Condition(s): Decompensated cirrhosis
Product: Microcrystalline cellulose, Lyophilized capsules of fecal microbiota

Primary endpoint: Efficacy of treatment in halting the progression of decompensated cirrhosis as assessed by time to first decompensation event (acute kidney injury (AKI), ascites, bacterial infection, gastrointestinal bleeding, Hepatic Encephalopathy (HE)) during the study period.
Endpoint(s): Time to transplant-free survival and mortality rates at month 1, month 3, month 6 and month 12., Development/worsening of individual complications of cirrhosis (ascites, AKI, bacterial infections, gastrointestinal bleeding, HE) assessed at baseline, month 1, month 3, month 6 and month 12., Frequency of hospital admissions due to complications of cirrhosis assessed at baseline, 1 month, 3 months, 6 months and 12 months., Development of acute-on-chronic liver failure (ACLF) defined according to criteria by Moreau R, et al. (Time to first episode of ACLF; Total number of patients developing ACLF at month 3, month 6 and month 12; Severity of ACLF episodes based on ACLF grade and CLIF-C-ACLF score; Number and type of organ failures)., Changes from baseline in systemic inflammatory response, evaluated by measurement in a large array of plasma cytokine levels including, but not limited to TNFα, IL-6, IL8, IL-10, IL-1β, IFN-ɣ, G-CSF, VCAM, VEGF, as well as an oxidized form of albumin, human nonmercaptalbumin-2 (HNA2) at 1 month, 3 months, 6 months and 12 months. PBMCs phenotype and function will be analysed by flow cytometry, functional analysis, and RNAseq single cell analysis at baseline, 1 month, 3 months, 6 months and 12 mo., Changes from baseline in different plasma and urine prognostic biomarkers including, but not only, copeptin, NGAL, PD-L1, L-FABP, at 1 month, 3 months, 6 months, and 12 months., Changes from baseline in systemic hemodynamics and vasoactive hormones: plasma renin concentration and plasma copeptin at 1 month, 3 months, 6 months and 12 months., Changes from baseline in blood levels of bacterial DNA or bacterial products at 1 month, 3 months, 6 months and 12 months., Changes from baseline in liver function, evaluated by MELD score, CLIF-AD score and Child Pugh Score at 1 month, 3 months, 6 months and 12 months., Analyze microbiome composition from saliva and stool by analysis of microbial genes at baseline, and months 1, 3 and 6., Changes in HVPG from baseline to month 6., The data obtained from CLDQ (Chronic Liver Disease Questionnaire), Liver Frailty Index and PHES (Psychometric Hepatic Encephalopathy Score) questionnaires to assess Quality of life, functional assessment and in Minimal Hepatic Encephalopathy at baseline, 3 months, 6 months and 12 months., Changes from baseline in AUDIT test at 3 months, 6 months and 12 months. Alcohol consumption will be monitorized by PETh measurement., Changes in ACE score to assess the effect of FMT in ECG at screening, baseline and months 3, 6 and 12., Proportion of patients and severity of treatment-related adverse events during the study period.

Source: https://euclinicaltrials.eu/ctis-public/view/2023-509151-13-00